EU clinical trial 2023-506642-23-01: A randomized, double-blind, placebo-controlled, multicenter study to assess the efficacy and safety of a 12-week administration of OATD-01, an oral inhibitor of chitinase-1 (CHIT1), for the treatment of active pulmonary sarcoidosis (the KITE study)
Protocol code: OATD-01-C-03
Sponsor: Molecure S.A. (Pharmaceutical company). Phase: Therapeutic exploratory (Phase II). Countries: Germany (ongoing, recruiting), France (ongoing, recruiting), Greece (authorised, recruiting), Denmark (authorised, recruiting), Norway (ongoing, recruiting), Netherlands (authorised, recruiting).
Therapeutic area(s): Diseases [C] - Respiratory Tract Diseases [C08]
Gender: Female, Male. Age: 18-64 years. Enrolment: 65.
Start date (EU): 2024-08-28. Decision date: 2024-05-16. Results received: No. Last updated: 2026-08-07.
Decision dates by country: DE: 2024-06-06, FR: 2024-06-06, NO: 2024-06-06, GR: 2024-06-06, DK: 2024-05-16, NL: 2025-08-14

Condition(s): Active Pulmonary Sarcoidosis
Product: OATD-01, Placebo

Primary endpoint: Response to treatment from baseline to End-of-Treatment (EOT) (i.e., complete or partial response) using the criteria determined for each subject
Endpoint(s): Granulomatous inflammation evaluated by [18F]FDG PET/CT imaging, quantified as the percent change of maximum, mean, peak SUV (SUVmax, SUVmean, SUVpeak), DocuSign Envelope ID: F57C5576-6512-4FF0-BFC4-DC20E82978C1 Study code OATD-01-C-03 Version 1.0, 21 June 2023 Confidential Clinical Study Protocol Page 9 of 75 and volume of the lesions in pulmonary parenchyma, mediastinal/hilar nodes, and extrathoracic locations, Absolute change in Forced Vital Capacity (FVC, % predicted) and Forced Expiratory Volume in the first second (FEV1), Change in the quality of life measured by the Kings Sarcoidosis Questionnaire General and Lung (KSQ GENERAL and LUNG) scores, Occurrence of Treatment-emerging Adverse Events (TEAEs), SAEs, Adverse Events of Special Interest (AESIs), TEAEs leading to discontinuation and TEAEs leading to death, Occurrence of clinically significant laboratory (hematology and biochemistry) parameter abnormalities, Change in the Fatigue Assessment Scale total score, Mean change in vital signs (systolic and diastolic blood pressure, heart rate, respiratory rate) from baseline to each post-baseline evaluation time point, Occurrence of any clinically significant abnormalities in 12- lead electrocardiography (ECG) or 24-h ECG, Change from baseline and in between visits in cardiac safety parameters evaluated by 12-lead ECG [Heart Rate (HR) , PR QTcF and QRS], Heart rhythm abnormalities including supraventricular arrhythmias, ventricular arrhythmias, and non-sustained ventricular tachycardias, Occurrence of a clinically significant abnormality of sperm parameters, Occurrence of clinically significant abnormality of free testosterone concentration, Occurrence of TEAEs of sensation abnormalities or ataxia, Proportion of subjects with clinically significant thyroid parameters (Thyroid Stimulating Hormone [TSH], Free Triiodothyronine [FT3], and Free Thyroxine [FT4] and renal function parameters [blood urea nitrogen (BUN)/total urea, creatinine, creatinine clearance (CrCL)], Mean plasma concentrations of OATD-01 measured at various timepoints post-baseline (sparse sampling)

Source: https://euclinicaltrials.eu/ctis-public/view/2023-506642-23-01